EU clinical trial 2024-518316-39-00: Ruxolitinib for childhood ALL in Poland (Rux-cALL-Pol 2020 trial) - Single-arm interventional study with ruxolitinib and AIEOP-BFM 2017 Poland or AIEOP-BFM 2017 standard of care chemotherapy in children with acute lymphoblastic leukemia and confirmed activation of JAK/STAT pathway.
Protocol code: Rux-cALL-Pol 2020
Sponsor: Medical University Of Lodz (Educational Institution). Phase: Phase II and Phase III (Integrated). Countries: Poland (ongoing, recruiting).
Therapeutic area(s): Diseases [C] - Neoplasms [C04]
Gender: Female, Male. Age: 0-17 years. Enrolment: 25.
Status: Ongoing, recruiting. Start date (EU): 2024-11-18. Decision date: 2024-11-18. Results received: No. Last updated: 2025-04-04.

Condition(s): Acute lymphoblastic leukemia
Product: METHOTREXATE DISODIUM, CYTARABINE, IFOSFAMIDE, CYTARABINE, RUXOLITINIB, VINDESINE SULFATE, IFOSFAMIDE, VINCRISTINE SULFATE, ETOPOSIDE, DEXAMETHASONE PHOSPHATE, CYCLOPHOSPHAMIDE, METHOTREXATE, ASPARAGINASE, DAUNORUBICIN, PEGASPARGASE, METHOTREXATE, DEXAMETHASONE, MERCAPTOPURINE, DOXORUBICIN HYDROCHLORIDE, RUXOLITINIB, DEXAMETHASONE, METHOTREXATE, METHOTREXATE, TIOGUANINE

Primary endpoint: Proportion of patients with MRD(-) at TP2.
Endpoint(s): Frequency and grading of adverse events in Consol. IB ext. phase (number, percentage, number per patient-days, number per each grade of significance)., Incidence of treatment-related adverse and severe adverse events.

Source: https://euclinicaltrials.eu/ctis-public/view/2024-518316-39-00